EU clinical trial 2024-512147-23-00: A Prospective, Open-Label, Phase IIb/III Study to Evaluate the Risk of TLS and Optimization of the Initiation of Venetoclax in Combination with Obinutuzumab or Acalabrutinib With Different Ramp-Up Periods in Previously Untreated Subjects with CLL
Protocol code: M24-287
Sponsor: AbbVie Deutschland GmbH & Co. KG (Pharmaceutical company). Phase: Phase II and Phase III (Integrated). Countries: France (ongoing, recruitment ended), Greece (ongoing, recruitment ended), Spain (ongoing, recruitment ended).
Therapeutic area(s): Diseases [C] - Hemic and Lymphatic Diseases [C15]
Gender: Female, Male. Age: 18-64 years, 65+ years. Enrolment: 161.
Status: Ongoing, recruitment ended. Start date (EU): 2024-11-21. Decision date: 2024-10-29. Results received: No. Last updated: 2026-06-08.
Decision dates by country: GR: 2024-11-05, FR: 2024-10-29, ES: 2024-11-04

Condition(s): Chronic Lymphocytic Leukemia
Product: Venetoclax, Venetoclax, Venetoclax, Calquence 100 mg film-coated tablets, Gazyvaro 1,000 mg concentrate for solution for infusion.

Primary endpoint: Part 1: Incidence of treatment-emergent laboratory TLS or treatment-emergent hyperkalemia per Howard criteria that require a clinical intervention that has been confirmed by an IRC assessment, Reduction of Tumor Burden from Baseline
Endpoint(s): Part 1: The incidence of treatment-emergent laboratory TLS or treatment-emergent hyperkalemia per Howard criteria that require a clinical intervention that has confirmed by an IRC assessment, Part 1: Incidence of Laboratory TLS per Howard criteria that require a clinical intervention that has been confirmed by an IRC assessment, Part 1: Incidence of Hyperkalemia per Howard criteria that require a clinical intervention that has been confirmed by an IRC assessment, Part 1: Incidence of Laboratory TLS per Howard criteria irrespective of clinical intervention, Part 1: Incidence of Hyperkalemia irrespective of clinical intervention, Part 1: Incidence of Clinical TLS per Howard criteria irrespective of clinical intervention, Part 1: Incidence of any single TLS-related lab abnormality requiring clinical intervention per Investigator (Hyperuricemia or Hyperphosphatemia or Hyperkalemia or Hypocalcemia), Adverse Events (AE) of TLS, Reduction of tumor burden from baseline

Source: https://euclinicaltrials.eu/ctis-public/view/2024-512147-23-00